EU clinical trial 2024-512605-29-01: Azithromycin for treatment of hospitalized children with asthmatic symptoms - A double-blind, randomized, controlled study
Protocol code: COPSACazt
Sponsor: Region Hovedstaden (Hospital/Clinic/Other health care facility). Phase: Therapeutic exploratory (Phase II). Countries: Denmark (ongoing, recruiting).
Therapeutic area(s): Diseases [C] - Respiratory Tract Diseases [C08]
Gender: Female, Male. Age: 0-17 years. Enrolment: 320.
Status: Ongoing, recruiting. Start date (EU): 2024-07-01. Decision date: 2024-06-14. Results received: No. Last updated: 2026-05-04.

Condition(s): Childhood asthma, Childhood asthma
Product: SODIUM PHOSPHATE DODECAHYDRATE, HYDROXYPROPYL CELLULOSE LF, BANANA FLAVOUR, SUCROSE, XANTHUM GUM, AZITHROMYCIN, Please see attached files

Primary endpoint: Duration (in days) of the asthma-like episode from the start of randomization.
Endpoint(s): 1) Change in symptom score from day 1 after randomization to completion of each randomized asthmatic episode aged 1-5 years assessed using a previously validated symptom scoring model based on a diary., 2) The length of hospitalization., 3) Need for SABA during the asthma-like episode., 4) Need for oral corticosteroids (OCS) during the asthma-like episode., 5) Stratification of the above analyzes on the basis of the presence or absence of bacteria in the airways., 6) Percentage of days away from daycare offers and / or work for parents / guardians., 7) Assessment of the health economic gain based on treatment costs and lost earnings for parent / guardian (s).

Source: https://euclinicaltrials.eu/ctis-public/view/2024-512605-29-01